EU clinical trial 2025-522718-22-00: ZANGEA – Phase II Study of Zanidatamab in Combination with Pembrolizumab and Chemotherapy in HER2 and PD-L1 Positive Metastatic Gastroesophageal Adenocarcinoma (GEA) Patients
Protocol code: IKF/AIO-ZANGEA
Sponsor: Frankfurter Institut Fuer Klinische Krebsforschung IKF GmbH (Pharmaceutical company). Phase: Therapeutic exploratory (Phase II). Countries: Germany (ongoing, recruiting).
Therapeutic area(s): Diseases [C] - Digestive System Diseases [C06]; Diseases [C] - Neoplasms [C04]
Gender: Female, Male. Age: 18-64 years, 65+ years. Enrolment: 80.
Status: Ongoing, recruiting. Start date (EU): 2025-12-16. Decision date: 2025-11-25. Results received: No. Last updated: 2026-07-22.
Decision dates by country: DE: 2026-01-16

Condition(s): Gastroesophageal Adenocarcinoma
Product: FOLIC ACID, JZP598, FLUOROURACIL, PEMBROLIZUMAB, OXALIPLATIN

Primary endpoint: Progression-free survival rate at 12 months (PFS@12), estimated using Kaplan Meier method and defined as proportion of patients alive and progression-free 12 months after start of trial medication
Endpoint(s): Overall response rate (ORR), defined as proportion of patients achieving complete or partial response (CR/PR) acc. to RECIST v1.1., Disease control rate (DCR), defined as proportion of patients achieving CR, PR, or stable disease (SD) acc. to RECIST v1.1., Duration of response (DoR), defined as time from response initiation (when either CR or PR is first determined) to disease progression acc. to RECIST v1.1 or death due to any cause., Progression-free survival (PFS), defined as time from first treatment until date of progression acc. to RECIST v1.1 or death due to any cause., Overall survival (OS), defined as time from first treatment until date of death due to any cause., Assessment of safety of the treatment as determined by the incidence, nature, causality, frequency, timing, and severity of adverse events using NCI CTCAE v5.0, Assessment of QoL during treatment and follow-up using EORTC QLQ- C30 and EQ-5D-5L questionnaires.

Source: https://euclinicaltrials.eu/ctis-public/view/2025-522718-22-00